EU clinical trial 2025-521215-39-00: A Global, Phase 3, Multicenter, Randomized, Double-Blind, Placebo-Controlled Study to Assess the Efficacy, Safety, and Tolerability of NBI-1117568 in Adults with Schizophrenia Who Warrant Inpatient Hospitalization
Protocol code: NBI-1117568-SCZ3030
Sponsor: Neurocrine Biosciences Inc. (Pharmaceutical company). Phase: Therapeutic confirmatory (Phase III). Countries: Hungary (authorised, recruiting), Romania (ongoing, recruiting), Bulgaria (ongoing, recruiting).
Therapeutic area(s): Psychiatry and Psychology [F] - Mental Disorders [F03]
Gender: Female, Male. Age: 18-64 years, 65+ years. Enrolment: 130.
Start date (EU): 2025-12-08. Decision date: 2025-11-07. Results received: No. Last updated: 2026-06-10.
Decision dates by country: RO: 2025-11-10, HU: 2025-11-07, BG: 2025-11-10

Condition(s): Schizophrenia
Product: NBI-1117568 Placebo Capsule, NBI-1117568, NBI-1117568

Primary endpoint: Change from baseline in PANSS total score at Week 5
Endpoint(s): Change from baseline in CGI-S score at Week 5

Source: https://euclinicaltrials.eu/ctis-public/view/2025-521215-39-00